EU clinical trial 2023-506945-42-00: A Safety Study of PF-08046040/SEA-CD70 in Patients with Myeloid Malignancies
Protocol code: SGNS70-101
Sponsor: Seagen Inc. (Pharmaceutical company). Phase: Human Pharmacology (Phase I)- First administration to humans. Countries: Netherlands (ongoing, recruiting).
Therapeutic area(s): Diseases [C] - Neoplasms [C04]
Gender: Female, Male. Age: 18-64 years, 65+ years. Enrolment: 8.
Status: Ongoing, recruiting. Start date (EU): 2022-01-21. Decision date: 2023-09-15. Results received: No. Last updated: 2026-04-01.

Condition(s): Acute myeloid leukaemia, Myeloid malignancies

Source: https://euclinicaltrials.eu/ctis-public/view/2023-506945-42-00